EU clinical trial 2026-526961-76-00: FLAsH-IV-AML: A phase I/II multi-center study to assess the tolerability and efficacy of the addition of hydroxyurea to salvage treatment with fludarabine, ara-C, idarubicin and venetoclax for adults with relapsed or refractory acute myeloid leukemia
Protocol code: FLAsH-IV-AML 1.0
Sponsor: Karolinska University Hospital (Hospital/Clinic/Other health care facility). Phase: Phase I and Phase II (Integrated)- Other. Countries: Sweden (authorised, recruitment pending).
Therapeutic area(s): Diseases [C] - Hemic and Lymphatic Diseases [C15]
Gender: Female, Male. Age: 18-64 years, 65+ years. Enrolment: 26.
Status: Authorised, recruitment pending. Decision date: 2026-07-14. Results received: No. Last updated: 2026-07-14.

Condition(s): Adults (≥ 18 years of age) with relapsed or refractory acute myeloid leukemia (R/R AML)
Product: Venclyxto 100 mg film-coated tablets, Zavedos, pulver till injektionsvätska, lösning, Fludarabine Teva 25 mg/ml solution à diluer pour solution injectable/pour perfusion, Hydroxyurea medac 500 mg kapsel, hård, Cytarabine Accord 100 mg/ml injektions-/infusionsvätska, lösning

Primary endpoint: 1-year EFS defined as from the time from initiation of study treatment to the first occurrence of treatment failure, hematologic relapse from CR/CRi, or death from any cause
Endpoint(s): Safety and tolerability (frequency and severity of non-hematological toxicities, including potential ara-C or fludarabine related neurological or dermatological adverse events)., Efficacy profile; 1- and 2-year OS, 2-year EFS, 1- and 2-year RFS, 1- and 2-year cumulative incidence of hematological relapse, response rates (CR, CRi, MLFS, PR, MRD-negativity)., Time to hematopoietic recovery (ANC 0.5 and 1.0 x 109/L; platelets 50 and 100 x 109/L) after each chemotherapy treatment cycle, defined as the time from the start of the cycle until recovery, Rate of patients bridged to allo-HCT, Rate of 30 and 60 day mortality, Rate of 30 and 60 day requirement of intensive care admission

Source: https://euclinicaltrials.eu/ctis-public/view/2026-526961-76-00